EU clinical trial 2023-508551-40-00: Dual antiplatelet therapy with ticagrelor and acetylsalicylic acid (ASA) vs. ASA only after isolated coronary artery bypass grafting in patients with acute coronary syndrome (TACSI trial)
Protocol code: TACSI-01
Sponsor: Vaestra Goetalandsregionen (Hospital/Clinic/Other health care facility). Phase: Therapeutic use (Phase IV). Countries: Finland (ongoing, recruitment ended), Iceland (ongoing, recruitment ended), Sweden (ongoing, recruitment ended), Denmark (ongoing, recruitment ended), Norway (ongoing, recruitment ended).
Therapeutic area(s): Diseases [C] - Cardiovascular Diseases [C14]
Gender: Female, Male. Age: 18-64 years, 65+ years. Enrolment: 2200.
Status: Ongoing, recruitment ended. Start date (EU): 2018-06-08. Decision date: 2024-10-23. Results received: No. Last updated: 2024-12-10.
Decision dates by country: DK: 2024-10-23, FI: 2024-10-23, NO: 2024-10-24, IS: 2024-12-10, SE: 2024-10-23

Condition(s): Coronary artery multi-vessel disease and left main stenosis
Product: ACETYLSALICYLIC ACID, ACETYLSALICYLIC ACID, ACETYLSALICYLIC ACID, ACETYLSALICYLIC ACID, TICAGRELOR, ACETYLSALICYLIC ACID

Primary endpoint: A composite endpoint of the time to all cause death, or myocardial infarction, or stroke, or new coronary revascularization within 12 months
Endpoint(s): Time to all cause death, Time to all cause death, myocardial infarction or stroke, Time to cardiovascular death, Time to first myocardial infarction, Time to first stroke, Time to new revascularization, Time to coronary angiography, Time to hospitalization for heart failure, Time to cardiovascular hospitalization, Time to sudden death or aborted cardiac arrest, Time to new-onset AF

Source: https://euclinicaltrials.eu/ctis-public/view/2023-508551-40-00